EU clinical trial 2023-510323-30-00: A phase 3 randomized, open-label study to evaluate the efficacy and safety of petosemtamab plus pembrolizumab vs pembrolizumab in first-line treatment of recurrent or metastatic PD-L1+ head and neck squamous cell carcinoma.
Protocol code: MCLA-158-CL03
Sponsor: Merus B.V. (Pharmaceutical company). Phase: Therapeutic confirmatory (Phase III). Countries: Greece (ongoing, recruiting), Spain (ongoing, recruiting), Germany (ongoing, recruiting), Poland (ongoing, recruiting), Netherlands (ongoing, recruiting), Belgium (ongoing, recruiting), Italy (ongoing, recruiting), France (ongoing, recruiting), Portugal (ongoing, recruiting), Czechia (ongoing, recruiting), Lithuania (ongoing, recruiting), Hungary (authorised, recruiting), Austria (ended), Croatia (ongoing, recruiting).
Therapeutic area(s): Diseases [C] - Neoplasms [C04]
Gender: Female, Male. Age: 18-64 years, 65+ years. Enrolment: 479.
Start date (EU): 2025-01-24. Decision date: 2024-08-27. Results received: No. Last updated: 2026-07-23.
Decision dates by country: HR: 2026-02-03, GR: 2024-08-27, HU: 2025-12-08, AT: 2026-02-07, PL: 2024-08-30, PT: 2025-11-12, IT: 2024-08-28, LT: 2025-12-04, BE: 2024-08-27, DE: 2024-08-30, ES: 2024-08-29, CZ: 2026-01-13, NL: 2024-09-02, FR: 2024-08-30

Condition(s): First-line treatment of recurrent or metastatic PD-L1+ head and neck squamous cell carcinoma.
Product: PEMBROLIZUMAB

Primary endpoint: 1. Objective response rate (ORR), 2. Overall survival (OS)
Endpoint(s): 1. PFS per RECIST v1.1 as assessed by investigator review, 2. The Duration of Response (DoR) per RECIST v1.1 and by investigator review, 3. The Clinical Benefit Rate (CBR) per RECIST v1.1 and by investigator review, 4. Percentage of participants with PFS at visit 1 and visit 2 per RECIST v1.1 as assessed by BICR

Source: https://euclinicaltrials.eu/ctis-public/view/2023-510323-30-00